EU clinical trial 2022-502478-18-00: HOVON 156 AML: A phase 3, multicenter, open-label, randomized, study of gilteritinib versus midostaurin in combination with induction and consolidation therapy followed by one-year maintenance in patients with newly diagnosed Acute Myeloid Leukemia (AML) or Myelodysplastic syndromes with excess blasts-2 (MDS-EB2) with FLT3 mutations eligible for intensive chemotherapy.
Protocol code: HO156
Sponsor: Hemato-Oncologie voor Volwassenen Nederland (Hovon) Stichting (Hospital/Clinic/Other health care facility). Phase: Therapeutic exploratory (Phase II). Countries: Lithuania (ongoing, recruitment ended), Austria (ongoing, recruitment ended), Germany (ongoing, recruitment ended), Ireland (ongoing, recruitment ended), Norway (ongoing, recruitment ended), Sweden (ongoing, recruitment ended), Belgium (ongoing, recruitment ended), France (ongoing, recruitment ended), Netherlands (ongoing, recruitment ended), Spain (ongoing, recruitment ended), Finland (ongoing, recruitment ended).
Therapeutic area(s): Diseases [C] - Neoplasms [C04]
Gender: Female, Male. Age: 18-64 years, 65+ years. Enrolment: 697.
Status: Ongoing, recruitment ended. Start date (EU): 2019-12-20. Decision date: 2024-08-01. Results received: No. Last updated: 2026-05-28.
Decision dates by country: AT: 2024-08-22, LT: 2024-08-13, ES: 2024-08-02, NO: 2024-08-07, SE: 2024-08-02, FI: 2024-08-02, IE: 2024-08-01, DE: 2024-08-05, FR: 2024-08-08, NL: 2024-08-01, BE: 2024-08-02

Condition(s): Acute Myeloid Leukemia (AML), MDS-EB2
Product: Rydapt 25 mg soft capsules, Xospata 40 mg film-coated tablets, Rydapt 25 mg soft capsules

Primary endpoint: Overall survival (OS), defined as the time from date of randomization to the date of death due to any cause. Patients still alive or lost to follow up will be censored at the time they were last known to be alive.
Endpoint(s): Event-free survival (EFS), defined as the time from randomization to failure to achieve CR after remission induction, death or relapse after achieving CR, whichever occurs first. A patient is said to have failed to achieve CR after remission induction if his/her best response during or at completion of the induction therapy is less than CR. Patients who achieved CR after remission induction and are not... (please find details in the protocol as this box is to limited), Complete remission (CR) rate after remission induction, defined as CR as best response during or at completion of the induction treatment, as determined by the Investigator, based on the European LeukemiaNet (ELN2017) recommended response criteria18, where CR is defined as: bone marrow blasts < 5%; absence of circulating blasts and blasts with Auer rods; absence of extramedullary disease; ANC ≥ 1.0 × 109/L (1000/μL); platelet count ≥ 100 × 109/L (100 000/μL) (see also Appendix B)., EFS with modified CR (mEFS) is defined similarly to EFS above. It is the time from randomization to failure to achieve CR after remission induction, death or relapse after achieving CR, whichever occurs first. However, a patient will be considered to have failed to achieve CR after remission induction if CR is not achieved within 60 days after the start of the last induction cycle. CR will be derived programmatically... (please find details in the protocol as this textfield is too limited), CR and CR with incomplete hematologic recovery (CRi) rates after induction cycle 1 andafter induction cycle 2, as determined by the Investigator, based on the European LeukemiaNet (ELN2017) recommended response criteria18, where CRi is defined as: all CR criteria except for residual neutropenia [<1.0 x 109/L (1000/μL)] or thrombocytopenia [<100 x 109/L (100 000/μL)] (See also Appendix B)., Relapse-free survival (RFS) after CR as determined by the Investigator, defined as time from the date of achievement of CR until relapse or death from any cause, whichever comes first. Patients still in first CR and alive or lost to follow up will be censored at the date of last clinical assessment., Cumulative incidence of relapse (CIR) after CR as determined by the Investigator, as measured from the date of achievement of CR until the date of relapse. Patients not known to have relapsed will be censored on the date of last clinical assessment. Patients who died without relapse will be counted as a competing cause of failure., Cumulative incidence of death (CID) after CR as determined by the Investigator, as measured from the date of achievement of CR until the date of death from any cause. Patients not known to have died will be censored on the date they were last known to be alive. Patients who experienced relapse in CR will be counted as competing cause of failure., CR without minimal residual disease (CRMRD-) rate after induction cycle 2, defined as CR as determined by the Investigator with negativity for a genetic marker by realtime quantitative polymerase chain reaction (RT-qPCR), and with negativity by multi-color flow cytometry, if studied pre-treatment., CR or CRi without minimal residual disease (CR/CRiMRD-) rate after induction cycle 2, defined as CR/CRi as determined by the Investigator with negativity for a genetic marker by realtime quantitative polymerase chain reaction (RT-qPCR), and with negativity by multi-color flow cytometry, if studied pre-treatment., Frequency and severity of adverse events according to CTCAE version 5.0, Time to hematopoietic recovery (ANC 0.5 and 1.0 x 109/L; platelets 50 and 100x 109/L) after each chemotherapy treatment cycle, defined as the time from the start of the cycle until recovery., Percentage of patients undergoing an allo-SCT., Quality of Life (QoL) during maintenance treatment.

Source: https://euclinicaltrials.eu/ctis-public/view/2022-502478-18-00